EU clinical trial 2023-509150-64-00: NXP800 in subjects with Ovarian Cancer
Protocol code: NXP800-101
Sponsor: Nuvectis Pharma Inc. (Pharmaceutical company). Phase: Human Pharmacology (Phase I)- First administration to humans. Countries: Spain (ended).
Therapeutic area(s): Diseases [C] - Neoplasms [C04]
Gender: Female. Age: 18-64 years, 65+ years. Enrolment: 8.
Status: Ended. End date (EU): 2025-08-05. End date: 2026-01-30. Decision date: 2024-03-25. Results received: No. Last updated: 2024-06-21.

Condition(s): Platinum-resistant, ARID1a-mutated ovarian, fallopian tube and primary peritoneal carcinoma

Source: https://euclinicaltrials.eu/ctis-public/view/2023-509150-64-00